EU clinical trial 2023-510136-36-00: A Study to Evaluate ARV-393 in Adult Participants with Advanced Non-Hodgkin’s Lymphoma
Protocol code: ARV-393-101
Sponsor: Arvinas Operations Inc. (Pharmaceutical company). Phase: Human Pharmacology (Phase I)- First administration to humans. Countries: Denmark (ongoing, recruiting), Spain (ongoing, recruiting), Italy (authorised, recruitment pending).
Therapeutic area(s): Diseases [C] - Neoplasms [C04]
Gender: Female, Male. Age: 18-64 years, 65+ years. Enrolment: 77.
Start date (EU): 2024-09-27. Decision date: 2024-09-10. Results received: No. Last updated: 2026-06-03.
Decision dates by country: ES: 2024-09-16, DK: 2024-09-10, IT: 2026-06-03

Condition(s): Advanced Non-Hodgkin’s Lymphoma

Source: https://euclinicaltrials.eu/ctis-public/view/2023-510136-36-00